EU clinical trial 2024-517723-39-00: A phase 1/2, dose and schedule evaluation study to investigate the safety and clinical activity of belantamab mafodotin administered in combination with lenalidomide and dexamethasone in patients with transplant ineligible newly diagnosed multiple myeloma
Protocol code: EAE128
Sponsor: Hellenic Society Of Hematology (Patient organisation/association). Phase: Therapeutic exploratory (Phase II). Countries: Greece (ongoing, recruitment ended).
Therapeutic area(s): Diseases [C] - Neoplasms [C04]
Gender: Female, Male. Age: 18-64 years, 65+ years. Enrolment: 6.
Status: Ongoing, recruitment ended. Start date (EU): 2023-06-23. Decision date: 2024-11-27. Results received: No. Last updated: 2025-12-09.

Condition(s): Newly diagnosed patients with multiple myeloma
Product: LENALIDOMIDE, LENALIDOMIDE, DEXAMETHASONE, LENALIDOMIDE, DEXAMETHASONE, LENALIDOMIDE, LENALIDOMIDE

Primary endpoint: • Number of participants with dose-limiting toxicities (DLTs). • Number of participants with AEs and serious adverse events (SAEs). • Number of participants with Grade 2 or above Keratopathy Visual Acuity (KVA) scale events
Endpoint(s): Lenalidomide Relative Dose Intensity (RDI)., Nirogacestat RDI., Cumulative administered dose of belantamab mafodotin in combination with lenalidomide, dexamethasone and nirogacestat., Overall Response Rate as per IMWG 2016 by Investigator Assessment, Time to Response (TTR) as per IMWG 2016 by Investigator Assessment., Duration of Response (DoR) as per IMWG 2016 by Investigator Assessment., Complete Response Rate (CRR) as per IMWG 2016 by Investigator Assessment., Number of participants that achieved at least VGPR., Minimal residual disease (MRD) negativity rate in the BM, Negative MRD is defined as the absence of tumor plasma cells within 100,000 (Sensitivity 10-5) BM cells. MRD will be assessed via next-generation flow (NGF) cytometry in participants with VGPR or better response., Progression-free Survival (PFS) as per IMWG 2016 by Investigator Assessment., Overall Survival (OS)., Number of participants with abnormal ocular findings (on ophthalmic exam)., Belantamab mafodotin dose holds., Number of participants with changes from baseline and proportion of participants with within-participant meaningful change in ocular self-reported symptoms and related impacts as measured by the OSDI questionnaire;)., Observed PK concentrations for belantamab mafodotin., Observed PK concentrations for nirogacestat.

Source: https://euclinicaltrials.eu/ctis-public/view/2024-517723-39-00